EU clinical trial 2024-517258-85-00: Optical PD-L1 imaging using Quantitative Fluorescence Endoscopy in locally advanced esophageal cancer using durvalumab-680LT: a phase I multicenter feasibility and safety study
Sponsor: Universitair Medisch Centrum Groningen (Hospital/Clinic/Other health care facility). Phase: Human Pharmacology (Phase I)- First administration to humans. Countries: Netherlands (ended).
Therapeutic area(s): Diseases [C] - Digestive System Diseases [C06]
Gender: Female, Male. Age: 18-64 years, 65+ years. Enrolment: 36.
Status: Ended. Start date (EU): 2024-11-21. End date (EU): 2024-12-05. Decision date: 2024-11-21. Results received: No. Last updated: 2024-11-21.

Condition(s): Esophageal cancer

Source: https://euclinicaltrials.eu/ctis-public/view/2024-517258-85-00